EU clinical trial 2024-516861-35-00: Cardiovascular safety assessment of Tanimilast in healthy volunteers
Protocol code: CLI-06001AA1-09
Sponsor: Chiesi Farmaceutici S.p.A. (Pharmaceutical company). Phase: Human Pharmacology (Phase I)- Other. Countries: Bulgaria (ended).
Therapeutic area(s): Diseases [C] - Respiratory Tract Diseases [C08]
Gender: Female, Male. Age: 18-64 years. Enrolment: 64.
Status: Ended. Start date (EU): 2025-07-31. End date (EU): 2025-10-13. Decision date: 2025-06-25. Results received: No. Last updated: 2025-07-29.

Condition(s): This is Phase I study to assess the effect on the heart rate (HR) and cardiovascular safety according to electrocardiographic monitoring (including QT and QTc intervals) of CHF6001(Tanimilast) administered with NEXThaler® device in healthy adult volunteers.

Source: https://euclinicaltrials.eu/ctis-public/view/2024-516861-35-00